EU clinical trial 2024-513092-40-00: Stopping or continuing platelet inhibitors after cryptogenic stroke at young age: STOP trial
Protocol code: 114180
Sponsor: Stichting Radboud universitair medisch centrum (Hospital/Clinic/Other health care facility). Phase: Therapeutic use (Phase IV). Countries: Netherlands (ongoing, recruiting).
Therapeutic area(s): Diseases [C] - Nervous System Diseases [C10]; Diseases [C] - Cardiovascular Diseases [C14]
Gender: Female, Male. Age: 18-64 years. Enrolment: 1316.
Status: Ongoing, recruiting. Start date (EU): 2024-12-05. Decision date: 2024-08-04. Results received: No. Last updated: 2026-02-12.

Condition(s): Stroke
Product: Plavix 75 mg film-coated tablets, Clopidogrel Viatris 75 mg film-coated tablets, ACETYLSALICYLIC ACID, DIPYRIDAMOLE

Primary endpoint: A composite endpoint of major vascular events, defined as TIA with imaging confirmation, stroke, myocardial infarction, or death from vascular causes.
Endpoint(s): Major bleeding, All-cause mortality, Cost-effectiveness, Quality of life

Source: https://euclinicaltrials.eu/ctis-public/view/2024-513092-40-00